EU clinical trial 2022-500424-30-00: A DOSE-BLINDED EXTENSION STUDY TO EVALUATE THE LONG-TERM EFFICACY, SAFETY, AND TOLERABILITY OF UCB0599 IN STUDY PARTICIPANTS WITH PARKINSON’S DISEASE
Protocol code: PD0055
Sponsor: UCB Biopharma (Pharmaceutical company). Phase: Therapeutic exploratory (Phase II). Countries: Netherlands (ended), Germany (ended), Spain (ended), Italy (ended), Poland (ended), France (ended).
Therapeutic area(s): Diseases [C] - Nervous System Diseases [C10]
Gender: Female, Male. Age: 18-64 years, 65+ years. Enrolment: 283.
Status: Ended. Start date (EU): 2022-12-28. End date (EU): 2025-03-19. End date: 2025-03-25. Decision date: 2022-11-29. Results received: Yes. Last updated: 2025-03-03.
Decision dates by country: PL: 2022-12-05, FR: 2022-11-29, NL: 2022-11-30, DE: 2022-11-30, IT: 2022-12-05, ES: 2022-12-02

Condition(s): Parkinson’s disease
Product: UCB0599 PRD4385815, Placebo matching UCB0599 and without active substance, IODINE IOFLUPANE (123I)

Primary endpoint: Baseline adjusted Dopamine Transporter Imaging with Single Photon Emission Computed Tomography (DaT-SPECT) whole striatum specific binding ratio (SBR) at PD0055 Month 18
Endpoint(s): - Cumulative Levodopa Equivalent Daily Dose; (LEDD) at PD0055 Month 18 - Incidence of treatment-emergent adverse event (TEAEs) - Incidence of serious adverse events (SAEs) - Incidence of TEAEs leading to withdrawal from study

Source: https://euclinicaltrials.eu/ctis-public/view/2022-500424-30-00